EU clinical trial 2025-522318-21-00: A Phase 1/2 open-label, multicenter study of oral GSK5460025 alone or in combination with other anti-cancer agents in adult participants with Mismatch Repair-deficient (dMMR) or Microsatellite Instability-High (MSI-H) solid tumors.
Protocol code: 224035
Sponsor: Glaxosmithkline Research & Development Limited (Pharmaceutical company). Phase: Phase I and Phase II (Integrated)- First administration to humans. Countries: Italy (authorised, recruitment pending), Denmark (authorised, recruitment pending), Spain (authorised, recruitment pending), Sweden (authorised, recruitment pending), Netherlands (authorised, recruitment pending), France (authorised, recruitment pending).
Therapeutic area(s): Diseases [C] - Neoplasms [C04]
Gender: Female, Male. Age: 18-64 years, 65+ years. Enrolment: 27.
Status: Authorised, recruitment pending. Decision date: 2026-04-14. Results received: No. Last updated: 2026-06-22.
Decision dates by country: IT: 2026-04-16, DK: 2026-05-04, FR: 2026-04-14, NL: 2026-05-11, ES: 2026-04-15, SE: 2026-04-15

Condition(s): Neoplasms, Colorectal

Primary endpoint: Part 1: Number of participants with dose limiting toxicities (DLTs) per dose level, Part 1: Number of participants with treatment emergent serious adverse events (TESAEs) and treatment emergent adverse events (TEAEs) by severity per dose level, Part 1: Duration of TESAEs and TEAEs per dose level, Part 1: Number of participants with TESAEs and TEAEs by severity per dose level during DLT observation period, Part 1: Number of participants with dosage modifications due to TEAEs per dose level, "Part 2: Objective Response Rate (ORR) ORR is defined as percentage of participants with confirmed complete response (CR) or partial response (PR) per Response Evaluation Criteria in Solid Tumors, version 1.1 (RECIST 1.1) by investigator assessment."
Endpoint(s): Part 1: Plasma concentrations for GSK5460025, Part 1: Area under the concentration-time curve (AUC) for GSK5460025, Part 1: Time to maximum concentration (Tmax) for GSK5460025, Part 1: Number of participants with clinically important changes in laboratory parameters, Electrocardiogram (ECGs), and vital signs per dose level, Part 2: Number of participants with TESAEs and TEAEs by severity, Part 2: Number of participants with TEAEs leading to dosage modifications, Part 2: Number of participants with clinically important changes in laboratory parameters, ECGs, and vital signs, PFS is defined as time from first dose to progressive disease (as assessed per RECIST 1.1 by Investigator assessment) or death from any cause, whichever is earlier, DoR is defined as time from first documented PR or CR to progressive disease (as assessed per RECIST 1.1 by investigator assessment) or death from any cause, whichever is earlier for participants who have achieved a confirmed CR or PR., Part 2: Plasma concentration of GSK5460025

Source: https://euclinicaltrials.eu/ctis-public/view/2025-522318-21-00